EU clinical trial 2025-523587-20-00: A trial to investigate the safety and pharmacokinetics of GRT6019 in healthy male participants.
Protocol code: HP6019-07
Sponsor: Gruenenthal GmbH (Pharmaceutical company). Phase: Human Pharmacology (Phase I)- Other. Countries: France (ended).
Therapeutic area(s): Not possible to specify
Gender: Male. Age: 18-64 years. Enrolment: 24.
Status: Ended. Start date (EU): 2026-01-05. End date (EU): 2026-07-11. Decision date: 2025-12-19. Results received: No. Last updated: 2025-12-19.

Condition(s): Not applicable for phase I study

Source: https://euclinicaltrials.eu/ctis-public/view/2025-523587-20-00